EU clinical trial 2023-506020-81-00: Experimental hypothermia using cold ambient temperature and drug-induced inhibition of shivering in awake, healthy volunteers: a crossover, double blinded trial
Sponsor: Helse Bergen HF (Hospital/Clinic/Other health care facility). Phase: Therapeutic exploratory (Phase II). Countries: Norway (ended).
Therapeutic area(s): Diseases [C] - Disorders of Environmental Origin [C21]; Phenomena and Processes [G] - Physiological processes [G07]
Gender: Female, Male. Age: 18-64 years. Enrolment: 16.
Status: Ended. Start date (EU): 2023-10-01. End date (EU): 2023-11-16. Decision date: 2023-09-29. Results received: Yes. Last updated: 2023-10-18.

Condition(s): Hypothermia
Product: PETHIDINE HYDROCHLORIDE, Naloxon B. Braun 0,4 mg/ml injeksjons-/infusjonsvæske, oppløsning, PLACEBO, Adrenalin 1 mg/ml injeksjonsvæske, oppløsning, Stesolid 5 mg/ml injeksjonsvæske, emulsjon, ONDANSETRON, SODIUM CHLORIDE, BUSPIRONE 10mg TABLETS

Primary endpoint: Temperature at termination. The experiment for a participant will be terminated if temperature reaches 35C or active cooling exceeds 3 hours or other reasons (technical problems, terminated by participant). Temperature will be measured at all timepoints. Temperature measurements by Body CAP capsule at all time points will function as backup.
Endpoint(s): Time from initiation of cooling to termination. Esophageal temperature at all time points. Temperature measurements by Body CAP capsule at all time points will function as backup., Composite score, resulting in shivering present (Yes/No), Respiratory rate, end-tidal pCO2, SpO2, blood pressure, heartrate, ECG, RASS, difference between temperature at termination and lowest temperature measured after extrication from cold exposure, thermal discomfort VAS(0-10), pain VAS (0-10), nausea yes/no (if yes: mild, moderate or severe), concentration of normeperidine at presumed maximum outside reference range, capillary blood glucose outside reference range measured 30 min after extrication from cold exposure, skin temperature <8C.

Source: https://euclinicaltrials.eu/ctis-public/view/2023-506020-81-00